EU clinical trial 2024-520244-41-00: The usage of unenriched emulsified fat transplant in temporomandibular joint degenerative diseases
Sponsor: Tartu University Hospital (Hospital/Clinic/Other health care facility). Phase: Therapeutic exploratory (Phase II). Countries: Estonia (authorised, recruitment pending).
Therapeutic area(s): Diseases [C] - Musculoskeletal Diseases [C05]; Diseases [C] - Stomatognathic Diseases [C07]
Gender: Female, Male. Age: 18-64 years. Enrolment: 14.
Status: Authorised, recruitment pending. Decision date: 2025-03-12. Results received: No. Last updated: 2025-03-12.

Condition(s): Temporomandibular joint osteoarthritis, Wilkes classification 4-5
Product: AUTOLOGOUS ADIPOSE TISSUE-DERIVED STROMAL VASCULAR FRACTION 5 MILLIONS CELLS

Primary endpoint: Collected radiological evaluations and questionnaires

Source: https://euclinicaltrials.eu/ctis-public/view/2024-520244-41-00